EU clinical trial 2024-516173-76-01: SURVIVE HERoes – A randomized Secondary Adjuvant Treatment Intervention study comparing Trastuzumab-Deruxtecan to SOC therapy in eBC Patients with Molecular Relapse
Protocol code: ESR-22-21837
Sponsor: Universitaetsklinikum Ulm AöR (Hospital/Clinic/Other health care facility). Phase: Therapeutic confirmatory (Phase III). Countries: Germany (ongoing, recruiting).
Therapeutic area(s): Diseases [C] - Neoplasms [C04]
Gender: Female, Male. Age: 18-64 years, 65+ years. Enrolment: 180.
Status: Ongoing, recruiting. Start date (EU): 2025-04-22. Decision date: 2024-12-20. Results received: No. Last updated: 2026-04-07.

Condition(s): HER2-positive or HER2-low (incl. ultra-low) early breast cancer
Product: Enhertu 100 mg powder for concentrate for solution for infusion

Primary endpoint: ctDNA clearance rate is defined as the proportion of patients with a ctDNA negative blood test result at a given time point
Endpoint(s): OS is defined as time from randomization until death from any cause. If a patient is not known to have died, OS is censored at the date of last contact., IDFS is defined as time from randomization until first IDFS event, including any invasive ipsilateral, regional, contralateral, and distant disease recurrence, second primary tumors, or death from any cause as event (non-invasive, in-situ cancer events are excluded). If a patient has not had an event, IDFS is censored at the date of last adequate tumor assessment. In addition to median IDFS, the 24 months IDFS rate will be calculated., DDFS is defined as time from randomization until first DDFS event including metastasis, second primary tumors and death from any cause as event. If a patient has not had an event, DDFS is censored at the date of last adequate tumor assessment., DRFS is defined as time from randomization until first DRFS event including metastasis and second primary tumors; death from any cause is not included as event. If a patient has not had an event, DRFS is censored at the date of last adequate tumor assessment. If a patient has died, DRFS is censored at the date of death., BCSS is defined as time from randomization until breast cancer associated death of the patient. If a patient is not known to have died, BCSS is censored at the date of last contact. If a patient has died for reasons not associated with breast cancer (by clinical assessment), BCSS is censored at the date of death., IBCFS is defined as time from randomization until first IBCFS event, including any invasive ipsilateral, regional, contralateral and distant disease recurrence or death from any cause as event (non-invasive, in-situ cancer events and second primary tumors are excluded). If a patient has not had an event, IBCFS is censored at the date of last adequate tumor assessment., ctDNA clearance rate is defined as the proportion of patients with a ctDNA negative blood test result at a given time point., QoL will be monitored and assessed in both groups using the two questionnaires EORTC QLQ-C30 and PA-F12, which must be completed before infusion of cycle 1 and at 3, 6, 9, 12, 15, 18, and 24 months after randomization., Safety and tolerability of study treatments will be assessed based on the frequencies and grades of serious adverse events (SAEs) and adverse events (AEs) during the course of the study. AE of special interest will include ILD, CHF and left ventricular dysfunction.

Source: https://euclinicaltrials.eu/ctis-public/view/2024-516173-76-01